EU clinical trial 2022-500366-10-00: Effect of orlistat on LIVER fat content in obese subjects with NAFLD and High concEntrAtion of pLasma proneurotensin THrough inhibition of neurotensin secretion and action
Sponsor: Region Skane (Hospital/Clinic/Other health care facility). Phase: Therapeutic exploratory (Phase II). Countries: Sweden (ended).
Therapeutic area(s): Diseases [C] - Nutritional and Metabolic Diseases [C18]
Gender: Female, Male. Age: 18-64 years, 65+ years. Enrolment: 60.
Status: Ended. Start date (EU): 2024-01-09. End date (EU): 2025-06-02. Decision date: 2023-01-26. Results received: No. Last updated: 2024-05-02.

Condition(s): Non-Alcoholic Fatty Liver Disease
Product: Orlistat STADA 120 mg hårda kapslar

Primary endpoint: The primary outcome is the treatment group difference in 6-month change (LFC% at week 24 – LFC% week -1) of absolute LFC%
Endpoint(s): Between group (orlistat vs control) difference of 24-week change in body weight, Between group (orlistat vs control) difference of 24-week change in insulin sensitivity (assessed by the “Homeostatic Model Assessment of insulin resistance”, “HOMA-IR”), Between group (orlistat vs control) difference of 24-week change in fasting plasma glucose., Between group (orlistat vs control) difference of 24-week change in plasma glucose 2-hours after a 75 gram oral glucose load, Between group (orlistat vs control) difference of 24-week change in plasma triglycerides, Between group (orlistat vs control) difference of 24-week change in plasma LDL-cholesterol, Between group (orlistat vs control) difference of 24-week change in systolic blood pressure, Between group (orlistat vs control) difference of 24-week change in HDL-cholesterol

Source: https://euclinicaltrials.eu/ctis-public/view/2022-500366-10-00